EU clinical trial 2025-520743-33-00: Phase 1b/2 dose-escalation trial of OMTX705, an anti-fibroblast activation protein antibody-drug conjugate, in combination with regorafenib and tislelizumab in patients with advanced/metastatic colorectal cancer
Protocol code: OMTX705-004
Sponsor: Oncomatryx Biopharma S.A. (Pharmaceutical company). Phase: Phase I and Phase II (Integrated)- Other. Countries: Spain (ongoing, recruiting).
Therapeutic area(s): Diseases [C] - Neoplasms [C04]
Gender: Female, Male. Age: 18-64 years. Enrolment: 69.
Status: Ongoing, recruiting. Start date (EU): 2025-07-23. Decision date: 2025-06-18. Results received: No. Last updated: 2026-01-28.
Decision dates by country: ES: 2025-07-21

Condition(s): Advanced/metastatic colorectal cancer
Product: Stivarga 40 mg film-coated tablets, Tevimbra 100 mg concentrate for solution for infusion, OMTX705

Primary endpoint: Safety and tolerability (for Part 1 and Part 2) will be assessed by: The nature and frequency of DLTs (Part 1 only). Frequency, duration, seriousness, relatedness, and severity of treatment emerging adverse events (TEAEs), per Common Terminology Criteria for Adverse Events, version 5.0., Changes in vital signs, serum chemistry, and hematology. Frequency of treatment modifications, measured as dose modifications, interruptions, or percentage of relative dose intensity. MTD dose or recommended Part 2 dose., Part 2 efficacy will be assessed by: The overall response rate (ORR), determined by the Investigator, according to Response Evaluation Criteria in Solid Tumors, version1.1 (RECIST 1.1).
Endpoint(s): Part 1 and 2: Additional efficacy endpoints will be evaluated by using RECIST 1.1: Response-associated endpoints: disease control rate (DCR= complete response [CR]+partial response [PR]+stable disease [SD]≥ 6, 12 and 21 weeks), duration of response, and time to response. Time-to-event efficacy endpoints: progression-free survival (PFS), proportion of participants without progression/death at 3, 6, and 12 months., Overall survival (OS) and proportion of participants alive at 3, 6, 12, and 18 months. Changes in carcino‐embryonic antigen (CEA) tumor biomarker from baseline upon treatment. For patients with other abnormal standard serum biomarkers, they will be followed., Part 1 and Part 2 immunogenicity of OMTX705 will be assessed by: Quantification (titer) of anti-drug antibodies (ADAs) against OMTX705 and percentage of ADA positive participants., Part 1 and Part 2 PK profile of OMTX705 with regorafenib/tislelizumab: Blood drug concentrations of total OMTX705, conjugated antibody, and unconjugated payload (TAM470), determined by non-compartmental analysis to derive main PK parameters (such as, maximum observed concentration [Cmax], time of first occurrence of Cmax [Tmax], area under the analytes concentration versus time curve from time 0 to time t [AUC0-t]).

Source: https://euclinicaltrials.eu/ctis-public/view/2025-520743-33-00